EU clinical trial 2024-518919-19-00: A single patient trial with Ataluren in one case of severe common variable immunodeficiency with autoimmunity due to homozygous stop codon mutations of LRBA
Protocol code: LRBA01
Sponsor: Centre Hospitalier Universitaire De Liege (Hospital/Clinic/Other health care facility). Phase: Therapeutic exploratory (Phase II). Countries: Belgium (ended).
Therapeutic area(s): Diseases [C] - Immune System Diseases [C20]
Gender: Male. Age: 18-64 years. Enrolment: 1.
Status: Ended. Start date (EU): 2021-07-09. End date (EU): 2025-07-31. Decision date: 2024-11-04. Results received: Yes. Last updated: 2024-11-04.

Condition(s): LRBA deficiency due homozygous nonsense mutations. It is a rare genetic disorder of the immune system caused by mutation in LRBA gene. This disease results in excessive number of immune cells calls lymphocytes ,autoimmunity, low levels of antibodies and recurrent infections. Excess of lymphocytes caused a variety of symptoms, the infiltration is most commun in the gut, lungs, and brain. LRBA deficiency (called LATAIE disease) may increase a person's risk of lymphoma, a type of cancer.
Product: Translarna 1000 mg granules for oral suspension, Translarna 250 mg granules for oral suspension

Primary endpoint: In comparison with a pre treatment period of five years improvement of quality of life, weight, diarrhea episode and number of hospitalisations
Endpoint(s): Expression of LRBA by PBMC, normalisation of CTLA4 expression of CD4 T cells. Normalisation of soluble CD25 and follicular T helper cells

Source: https://euclinicaltrials.eu/ctis-public/view/2024-518919-19-00